EU clinical trial 2024-516000-41-01: Treatment with Indapamide in Patients with Post-Surgical Hypoparathyroidism
Sponsor: Region Midtjylland (Hospital/Clinic/Other health care facility). Phase: Therapeutic use (Phase IV). Countries: Denmark (ongoing, recruiting).
Therapeutic area(s): Diseases [C] - Musculoskeletal Diseases [C05]
Gender: Female, Male. Age: 18-64 years, 65+ years. Enrolment: 30.
Status: Ongoing, recruiting. Start date (EU): 2025-06-04. Decision date: 2025-02-26. Results received: No. Last updated: 2026-07-28.

Condition(s): Hypoparathyroidism
Product: Placebo tablets, INDAPAMIDE

Primary endpoint: Changes in 24-hour urinary calcium excretion after 14 days of treatment
Endpoint(s): Changes in plasma ionized calcium after 7 and 14 days of treatment, Changes in supplementation with active vitamin D and oral calcium after 7 and 14 days of treatment, Changes in plasma ionized calcium in the placebo period due to a sodium restrictive diet, Changes in 24-hour urinary calcium excretion in the placebo period due to a sodium restrictive diet

Source: https://euclinicaltrials.eu/ctis-public/view/2024-516000-41-01